EU clinical trial 2025-523300-77-00: Bioequivalence of Testosterone Transdermal Gel in Healthy Female Participants.
Protocol code: BLCL-TES-EU-02
Sponsor: Laboratorios Leon Farma S.A. (Pharmaceutical company). Phase: Human Pharmacology (Phase I)- Bioequivalence Study. Countries: Portugal (ended).
Therapeutic area(s): Not possible to specify
Gender: Female. Age: 18-64 years, 65+ years. Enrolment: 48.
Status: Ended. Start date (EU): 2026-01-26. End date (EU): 2026-04-10. Decision date: 2025-11-04. Results received: No. Last updated: 2026-01-21.

Condition(s): No medical conditions.

Source: https://euclinicaltrials.eu/ctis-public/view/2025-523300-77-00